EU clinical trial 2024-514359-14-00: A Study to Investigate the Pharmacokinetics, Safety and Tolerability of AZD5462 in Participants with Renal Impairment
Protocol code: D9090C00010
Sponsor: AstraZeneca AB (Pharmaceutical company). Phase: Human Pharmacology (Phase I)- Other. Countries: Bulgaria (ended).
Therapeutic area(s): Diseases [C] - Male Urogenital Diseases [C12]; Diseases [C] - Female Urogenital Diseases and Pregnancy Complications [C13]
Gender: Female, Male. Age: 18-64 years, 65+ years. Enrolment: 32.
Status: Ended. Start date (EU): 2024-11-18. End date (EU): 2025-03-20. Decision date: 2024-10-28. Results received: No. Last updated: 2025-03-10.

Condition(s): Impaired renal function

Source: https://euclinicaltrials.eu/ctis-public/view/2024-514359-14-00